EU clinical trial 2023-507459-31-03: A Phase 3, Randomized, Double-Blind, Parallel Group, Multicenter Study to Compare Efficacy, Safety, Pharmacokinetics, and Immunogenicity of BP05 Versus EU-Approved Lucentis® in Patients with Wet (Neovascular) Age-Related Macular Degeneration
Protocol code: CR213-20
Sponsor: Curateq Biologics Private Limited (Pharmaceutical company). Phase: Therapeutic confirmatory (Phase III). Countries: Slovakia (ended), Latvia (ended).
Therapeutic area(s): Diseases [C] - Eye Diseases [C11]
Gender: Female, Male. Age: 18-64 years, 65+ years. Enrolment: 70.
Status: Ended. Start date (EU): 2024-05-22. End date (EU): 2025-10-14. Decision date: 2024-05-21. Results received: No. Last updated: 2025-05-16.
Decision dates by country: SK: 2024-05-21, LV: 2024-07-16

Condition(s): wet macula degeneration
Product: Lucentis 10 mg/ml solution for injection, Ranibizumab

Primary endpoint: Change in BCVA letters at Week 8, compared with baseline, in the study eye using the ETDRS chart
Endpoint(s): Change in BCVA letters over the course of the study compared with baseline in the study eye using the ETDRS chart, Change in total size of CNV leakage area at Week 24 and Week 52 compared with baseline in the study eye, as measured by FA, Change in total size of CNV at Week 24 and Week 52 compared with baseline in the study eye, as measured by FA, Change in CFT at Week 4, Week 8, Week 16, Week 24, and Week 52 compared with baseline in the study eye, as measured by spectral domain OCT, Percentage of patients with loss of ≤15 letters using ETDRS, evaluated as change at Week 8, Week 24, and Week 52 compared with baseline in the study eye, Percentage of patients with gain of >15 letters using ETDRS, evaluated as change at Week 8, Week 24, and Week 52 compared with baseline in the study eye, Change in intra/subretinal fluid status at Week 24 and Week 52 compared with baseline in the study eye, as measured by OCT, Number of patients without intra/subretinal fluid at Week 24 and Week 52 in the study eye, Drug concentrations (Cmax) analyzed after the collection of blood at the following time points: o Before administration of the study drug at Cycle 1 o 22 hours ± 1 hour after the administration of the first and the sixth dose, Incidence of ADAs to ranibizumab measured at pre-dose on Day 1, Week 4, Week 12, Week 20, Week 36, and Week 52, Incidence of NAbs will be performed in all the ADA-positive patients, Adverse events, as defined by TEAEs, SAEs, AESIs, related TEAEs, and related SAEs, Injection site reactions, Intraocular inflammation, Laboratory parameters (hematology, clinical chemistry, urinalysis, etc.), Intraocular pressure and perfusion of the optic nerve

Source: https://euclinicaltrials.eu/ctis-public/view/2023-507459-31-03